EU clinical trial 2023-507959-29-00: A Phase I, open-label, non-randomized study to evaluate the absorption, distribution, metabolism and excretion and pharmacokinetics of DLX313 (minzasolmin) following a single oral dose of [14C]DLX313 in healthy male participants
Protocol code: CDLX313A12101
Sponsor: Novartis Pharma AG (Pharmaceutical company). Phase: Human Pharmacology (Phase I)- Other. Countries: Netherlands (ended).
Therapeutic area(s): Diseases [C] - Nervous System Diseases [C10]
Gender: Male. Age: 18-64 years. Enrolment: 6.
Status: Ended. Start date (EU): 2024-07-19. End date (EU): 2024-09-14. End date: 2024-09-15. Decision date: 2024-07-16. Results received: No. Last updated: 2024-08-12.
Decision dates by country: NL: 2024-08-12

Condition(s): Parkinson’s Disease

Source: https://euclinicaltrials.eu/ctis-public/view/2023-507959-29-00